EU clinical trial 2023-503679-12-00: A First-in-Human Dose Escalation Study of JNJ-79635322, in Participants with Relapsed or Refractory Multiple Myeloma or Previously Treated AL Amyloidosis
Protocol code: 79635322MMY1001
Sponsor: Janssen - Cilag International (Pharmaceutical company). Phase: Human Pharmacology (Phase I)- First administration to humans. Countries: Netherlands (ongoing, recruiting), Belgium (ongoing, recruiting), Spain (ongoing, recruiting), France (ongoing, recruiting).
Therapeutic area(s): Diseases [C] - Neoplasms [C04]
Gender: Female, Male. Age: 18-64 years, 65+ years. Enrolment: 75.
Status: Ongoing, recruiting. Start date (EU): 2022-11-21. Decision date: 2023-08-09. Results received: No. Last updated: 2026-03-04.
Decision dates by country: FR: 2023-08-25, ES: 2023-08-09, BE: 2023-08-09, NL: 2023-08-09

Condition(s): Relapsed or Refractory Multiple Myeloma, Previously Treated AL Amyloidosis

Source: https://euclinicaltrials.eu/ctis-public/view/2023-503679-12-00